EU clinical trial 2025-522492-28-00: Master Protocol Full Title: A Master Protocol for an Exploratory, Phase 2a, Proof-of-Concept Platform Study to Evaluate the Safety, Tolerability, and Efficacy of Multiple Regimens in Participants With Myasthenia Gravis. ISA 1 Full Title: An ISA to Master Protocol ARGX-999-2-MG-2000 for an Exploratory, Phase 2a, Proof-of-Concept Study to Evaluate the Safety, Tolerability, and Efficacy of Empasiprubart IV as Add-On Therapy to Efgartigimod IV in Participants With AChR-Ab Seropositive Generalized Myasthenia Gravis With a Partial Clinical Response to Efgartigimod.
Protocol code: ARGX-999-2-MG-20001
Sponsor: Argenx (Pharmaceutical company). Phase: Therapeutic exploratory (Phase II). Countries: Spain (authorised, recruiting), Poland (ongoing, recruiting), Germany (authorised, recruiting), Netherlands (authorised, recruiting), Greece (ongoing, recruiting), Italy (authorised, recruiting), Belgium (ongoing, recruiting).
Therapeutic area(s): Diseases [C] - Immune System Diseases [C20]
Gender: Female, Male. Age: 18-64 years, 65+ years. Enrolment: 52.
Start date (EU): 2026-03-13. Decision date: 2026-02-18. Results received: No. Last updated: 2026-06-22.
Decision dates by country: IT: 2026-02-23, ES: 2026-02-20, NL: 2026-02-20, BE: 2026-02-18, DE: 2026-02-24, GR: 2026-02-24, PL: 2026-02-22

Condition(s): AChR-Ab Seropositive Generalized Myasthenia Gravis, Myasthenia Gravis, MG, gMG
Product: ARGX-117, ARGX-113

Primary endpoint: MP - 1. Incidence, severity, and relatedness of AEs and SAEs, MP - 2. Clinically meaningful changes in vital signs, ECGs, and laboratory parameters, ISA 1 - 1. Incidence, severity, and relatedness of adverse events and serious adverse events in parts A and B, ISA 1 - 2. Clinically meaningful changes in vital signs, electrocardio grams, and laboratory parameters in parts A and B
Endpoint(s): MP - 1. Change in MG disease severity as measured by change from baseline in Myasthenia Gravis Activities of Daily Living (MG-ADL) total score or Myasthenia Gravis Impairment Index (MGII) total score, MP - 2. Proportion of participants reaching minimal symptom expression (MSE) and other percentage improvements at variable time points., ISA1 - 1. Myasthenia Gravis Activities of Daily Living (MG-ADL) total score change from baseline at week 18 in part B (cycle 2 day 29) compared with MG-ADL total score change from baseline at week 4 in part A, ISA 1 - 2. Proportion of participants reaching minimal symptom expression (MSE) at any point in part B cycles 1 and 2, and part B cycles 1 or 2, ISA 1 - 3. MG-ADL total score actual values and changes from baseline over time in part B compared with part A, ISA 1 - 4. Quantitative Myasthenia Gravis (QMG) total score change from baseline at week 18 in part B (cycle 2 day 29) compared with QMG total score change from baseline at week 4 in part A, ISA 1 - 5. QMG total score actual values and changes from baseline over time in part B compared with part A, ISA 1 - 6. Proportion of participants who have a 50% MG-ADL total score improvement in part B cycles 1 and 2, ISA 1 - 7. Proportion of participants who have positive patient acceptable symptom state (PASS) in part B cycles 1 and 2, and part B cycles 1 or 2

Source: https://euclinicaltrials.eu/ctis-public/view/2025-522492-28-00